EU clinical trial 2024-511870-65-00: Diabete RemIssion using Fecal TransfER post bariatric surgery (DRIFTER)
Protocol code: APHP180591
Sponsor: Assistance Publique Hopitaux De Paris (Hospital/Clinic/Other health care facility). Phase: Therapeutic confirmatory (Phase III). Countries: France (ongoing, recruiting).
Therapeutic area(s): Diseases [C] - Nutritional and Metabolic Diseases [C18]
Gender: Female, Male. Age: 18-64 years. Enrolment: 94.
Status: Ongoing, recruiting. Start date (EU): 2024-01-16. Decision date: 2024-11-06. Results received: No. Last updated: 2024-11-06.

Condition(s): Adults Non Diabete Remission (NDR) Type 2 Diabete (T2D) patients 1 to 5 years after bariatric surgery
Product: Placebo double encapsulated oral transplant of fecal microbiota, Double encapsulated oral transplant of fecal microbiota

Primary endpoint: Hba1c change from baseline to 6 months post randomization (we expect at least -0.75%)
Endpoint(s): Evolution of Hba1c from baseline to 2 years post randomization Hba1c will be measured at the following visits: baseline 6, 12, 18, 24W, 1 and 2 years post randomization, Evolution of C-peptide from baseline to 2 years post randomization C-peptide will be measured at the following visits: baseline 6, 12, 18, 24W, 1 and 2 years post randomization, Evolution of insulin secretion from baseline to 24W using the HOMA-B calculator (=20 × fasting insulin (μIU/ml)/ fasting glucose (mmol/ml) − 3.5), Evolution of insulin resistance from baseline to 24W: we will use the HOMA-IR (= fasting insulin (μIU/ml) × fasting glucose (mmol/ml)/ 22.5) and Disse index (=Disse 12*((2.5*(HDL-total cholesterol)-NEFA)-insulin)) which are two complementary markers to evaluate insulin resistance using different parameters., Glycaemia profile (using glycemic holter) changes from baseline to 6W and 24W, Number of antiT2D drugs. The number of concomitant anti-diabetic drugs will be analysed at baseline and at 1 and 2 years’ post-randomization., Type of antiT2D drugs. The type of anti-diabetic drugs will be analysed at baseline and 1 and 2 years’ post-randomization, modifications will be described., Number of patients reaching DR. Proportion of patients reaching DR (partial or complete) at 24W and maintaining it at 1 and 2 years. Partial diabetes remission (PDR) is defined as Hba1c <6.5% and FPG <7.0 mmol/l without the need of glucose- lowering agents. Complete diabetes remission (CDR) is defined as Hba1c <6.0% and FPG <5.6 mmol/l without glucose-lowering agents, Proportion of patient needing a “safety” glucose lowering treatment to control Hba1c despite FMTs, Describe how long the FMT effects last (i.e. time with 1st HbA1c at least 0.15% lower than baseline value), Describe how many FMT cures are needed to obtain the primary end-point (-0.75% reduction of Hba1c), Evaluate the proportion of good responders’ patients (Good responders are defined in the protocol), Identify characteristics of good response related to the receiver (more detail in protocol), Identify characteristics of good response related to good donor’s (i.e. factors from the donor associated with good response in the receiver), Identify gut microbiota signature (i.e. dominant/subdominant bacteria/taxa/ genus/ species) associated with good response of FMT, in the receiver post-FMT (at 6 and 12W) (metagenomic analysis as described above), Changes in gut microbiota MGR and microbiota composition in receivers from baseline to 6, 18 and 24W follow-up (with further comparison between good/bad responders), Changes in systemic gut microbiota related metabolites (LC-MS metabolomics) from baseline to 6, 18 and 24W), Evaluate FMT safety (more detail in protocol), Evaluate changes in quality of life after capsulized FMT (baseline vs. after FMT and between treatment groups using SF36 questionnaire)

Source: https://euclinicaltrials.eu/ctis-public/view/2024-511870-65-00